EU clinical trial 2023-503558-10-00: Intensified treatment in patients with oligometastatic pancreatic cancer - multimodal surgical treatment versus systemic chemotherapy alone: a randomized controlled trial - METAPANC
Protocol code: 1.3
Sponsor: Universitaetsmedizin Goettingen (Hospital/Clinic/Other health care facility). Phase: Therapeutic confirmatory (Phase III). Countries: Germany (ongoing, recruiting), Sweden (ongoing, recruiting), Finland (authorised, recruitment pending), Netherlands (authorised, recruitment pending).
Therapeutic area(s): Diseases [C] - Neoplasms [C04]; Analytical,Diagnostic,Therapeutic Techniques and Equipment [E]-Surgical Procedures, Operative [E04]
Gender: Female, Male. Age: 18-64 years, 65+ years. Enrolment: 500.
Start date (EU): 2023-10-13. Decision date: 2023-08-11. Results received: No. Last updated: 2026-03-18.
Decision dates by country: SE: 2024-05-29, FI: 2025-04-09, DE: 2023-08-11, NL: 2025-10-24

Condition(s): oligometastatic pancreatic cancer
Product: Oxaliplatin, Fluorouracil, Irinotecan, Calcium Folinate

Primary endpoint: Overall Survival (OS): Time from randomization to death from any cause or EOS
Endpoint(s): Progression-free survival (PFS): Time of randomization to cancer progression or death or EOS, Procedure related complications and mortality, Quality of life (EORTC QLQ-C30, PAN-26, CIPN20), Quality-adjusted Time without Symptoms and Toxicity (Q-TWIST) Assessment of safety, General safety of surgical removal of tumor and metastases in patients with oligometastatic pancreatic cancer

Source: https://euclinicaltrials.eu/ctis-public/view/2023-503558-10-00